EU clinical trial 2023-510374-13-00: Intra-arterial t-PA infusion during mechanical thrombectomy in acute ischemic stroke: a randomized trial.
Protocol code: Vanish Trial
Sponsor: Vall D'hebron Institut De Recerca (Laboratory/Research/Testing facility). Phase: Therapeutic confirmatory (Phase III). Countries: Spain (authorised, recruitment pending).
Therapeutic area(s): Diseases [C] - Nervous System Diseases [C10]
Gender: Female, Male. Age: 18-64 years, 65+ years. Enrolment: 120.
Status: Authorised, recruitment pending. Decision date: 2024-05-13. Results received: No. Last updated: 2024-05-13.

Condition(s): People with acute ischemic stroke (AIS) due to large vessel occlusion of the anterior circulation.
Product: Actilyse, polvo y disolvente para solución inyectable y para perfusión, Actilyse, polvo y disolvente para solución inyectable y para perfusión

Primary endpoint: The proportion of patients achieving a mRS 0-1
Endpoint(s): The proportion of patients with dramatic clinical recovery (DCR). DCR will be defined as a decrease of ≥8 points from baseline NIHSS or a 24-hour NIHSS score ≤2., The proportion of patients achieving a mRS 0-2, The proportion of hemorrhagic complications. A non-contrast CT will be performed after 24 to 48 hours to evaluate the presence and degree of hemorrhagic transformation according to the ECASS-II criteria[3]., The proportion of symptomatic intracerebral hemorrhage (sICH), The proportion of death due to any cause, The proportion of patients who suffer a Safety Outcome. Safety outcome will be defined as the proportion of patients with the composite of: (i) symptomatic intracranial hemorrhage (ii) major bleeding due to access complications including groin hematoma, retroperitoneal hematoma (iii) contrast nephropathy., The proportion of patients discharged at home with or without services

Source: https://euclinicaltrials.eu/ctis-public/view/2023-510374-13-00